EU clinical trial 2024-516322-60-00: PHASE IB/II STUDY TO EVALUATE SAFETY AND EFFICACY OF DEBIO 0123 AND SACITUZUMAB GOVITECAN IN TNBC OR HR+/HER2- ADVANCED/ METASTATIC BREAST CANCER (WIN-B)
Protocol code: MEDOPP0621
Sponsor: Medica Scientia Innovation Research S.L. (Pharmaceutical company). Phase: Phase I and Phase II (Integrated)- Other. Countries: Spain (temporarily halted).
Therapeutic area(s): Diseases [C] - Neoplasms [C04]
Gender: Female, Male. Age: 18-64 years, 65+ years. Enrolment: 40.
Status: Temporarily halted. Start date (EU): 2025-01-17. Decision date: 2024-11-07. Results received: No. Last updated: 2025-10-30.

Condition(s): TRIPLE-NEGATIVE OR HR+/HER2– ADVANCED/METASTATIC BREAST CANCER, Triple-negative or hormonal receptor positive/human epidermal growth factor receptor 2 negative advanced/metastatic breast cancer.

Source: https://euclinicaltrials.eu/ctis-public/view/2024-516322-60-00